EU clinical trial 2023-503657-35-00: J1I-MC-GZBJ: A Master Protocol to Investigate the Efficacy and Safety of LY3437943 Once Weekly in Participants Without Type 2 Diabetes Who Have Obesity or Overweight: A Randomized, Double-Blind, Placebo-Controlled Trial (TRIUMPH-1); J1I-MC-GOA1: Indication-Specific Appendix (ISA2) for participants with knee osteoarthritis (OA)
Protocol code: J1I-MC-GZBJ, -GOA1
Sponsor: Eli Lilly & Co. (Pharmaceutical company). Phase: Therapeutic confirmatory (Phase III). Countries: Romania (ended), Poland (ended), Hungary (ended), Spain (ended).
Therapeutic area(s): Diseases [C] - Nutritional and Metabolic Diseases [C18]
Gender: Female, Male. Age: 18-64 years, 65+ years. Enrolment: 440.
Status: Ended. Start date (EU): 2023-10-10. End date (EU): 2026-04-09. End date: 2026-04-30. Decision date: 2023-09-28. Results received: No. Last updated: 2025-10-07.
Decision dates by country: HU: 2023-09-28, RO: 2023-10-02, ES: 2023-10-02, PL: 2023-10-02

Condition(s): Obesity, Overweight, Osteoarthritis, Knee
Product: Retatrutide, Retatrutide, Placebo injection, Retatrutide, Retatrutide, Retatrutide

Primary endpoint: Percent Change from Baseline in Body Weight, Change from Baseline in the Western Ontario and McMaster Universities Osteoarthritis Index (WOMAC) Pain Subscale Score for GOA1 Subset

Source: https://euclinicaltrials.eu/ctis-public/view/2023-503657-35-00